EU clinical trial 2023-508644-22-00: Phase I/Ib clinical trial of PM54 in Advance Solid Tumors patients
Sponsor: Pharma Mar S.A. (Pharmaceutical company). Phase: Phase I and Phase II (Integrated)- First administration to humans. Countries: Spain (ongoing, recruiting), Belgium (ongoing, recruiting), France (ongoing, recruiting).
Therapeutic area(s): Diseases [C] - Neoplasms [C04]
Gender: Female, Male. Age: 18-64 years, 65+ years. Enrolment: 193.
Status: Ongoing, recruiting. Start date (EU): 2023-02-28. Decision date: 2023-11-14. Results received: No. Last updated: 2026-06-22.
Decision dates by country: ES: 2023-11-14, FR: 2025-01-15, BE: 2023-12-05

Condition(s): Advance Solid Tumors

Source: https://euclinicaltrials.eu/ctis-public/view/2023-508644-22-00